EU clinical trial 2023-506008-20-00: DAREON™-8: A study to test how well different doses of BI 764532 in addition to standard of care are tolerated by people with advanced small cell lung cancer
Protocol code: 1438-0008
Sponsor: Boehringer Ingelheim International GmbH, Boehringer Ingelheim RCV GmbH & Co. KG, Boehringer Ingelheim Espana S.A. (Pharmaceutical company). Phase: Human Pharmacology (Phase I)- Other. Countries: Poland (ongoing, recruitment ended), Belgium (ended), France (ongoing, recruitment ended), Germany (authorised, recruiting), Spain (ongoing, recruitment ended).
Therapeutic area(s): Diseases [C] - Neoplasms [C04]
Gender: Female, Male. Age: 18-64 years, 65+ years. Enrolment: 40.
Start date (EU): 2024-01-11. Decision date: 2023-12-06. Results received: No. Last updated: 2026-05-19.
Decision dates by country: BE: 2023-12-11, DE: 2023-12-07, PL: 2023-12-06, ES: 2023-12-11, FR: 2023-12-11

Condition(s): Extensive-stage small cell lung carcinoma (ES-SCLC)

Source: https://euclinicaltrials.eu/ctis-public/view/2023-506008-20-00